EU clinical trial 2024-514104-14-00: TALAMESO : A Three-Cohort Phase II trial to Assess the Efficacy of a Maintenance Treatment with TALAzoparib following First Line Platinum-based Chemotherapy in Pleural or Malignant Peritoneal MESOthelioma Patients
Protocol code: 69HCL19_0457
Sponsor: Hospices Civils De Lyon (Hospital/Clinic/Other health care facility). Phase: Therapeutic exploratory (Phase II). Countries: France (ongoing, recruitment ended).
Therapeutic area(s): Not possible to specify
Gender: Female, Male. Age: 18-64 years, 65+ years. Enrolment: 40.
Status: Ongoing, recruitment ended. Start date (EU): 2020-11-04. Decision date: 2024-08-21. Results received: No. Last updated: 2025-12-19.

Condition(s): Adults subjects with advanced malignant pleural (cohort A) or peritoneal (cohorts B1 and B2) mesothelioma.
Product: Talzenna 1 mg hard capsules

Primary endpoint: Non-progression proportion 6 months after starting talazoparib in TALAMESO trial.
Endpoint(s): Related to progression free-survival based on RECIST 1.1 criteria (only for Malignant Peritoneal Mesothelioma), Related to progression free-survival based on mRECIST criteria (For Malignant Peritoneal Mesothelioma and Malignant Pleural Mesothelioma), Related to overall survival, Related to safety, Translational endpoints : On FFPE (paraffin embedded archival blocks) pretreatment tumor samples : BAP1 and HR genes status, Translational endpoints : On FFPE (paraffin embedded archival blocks) pretreatment tumor samples : RAD51 foci assay, Translational endpoints : On FFPE (paraffin embedded archival blocks) pretreatment tumor samples : HRD transcriptomic signature

Source: https://euclinicaltrials.eu/ctis-public/view/2024-514104-14-00